EU clinical trial 2022-503080-15-00: A Phase 1, open-label, multiple-ascending dose study to investigate the safety, pharmacokinetics, pharmacodynamics, and preliminary efficacy of KD033 (SAR445710) in subjects with metastatic or locally advanced solid tumors
Protocol code: TED17644
Sponsor: Kadmon Corporation LLC (Pharmaceutical company). Phase: Human Pharmacology (Phase I)- First administration to humans. Countries: France (ended), Spain (ended).
Therapeutic area(s): Diseases [C] - Neoplasms [C04]
Gender: Female, Male. Age: 18-64 years, 65+ years. Enrolment: 30.
Status: Ended. End date (EU): 2023-10-24. End date: 2023-12-01. Decision date: 2023-07-18. Results received: Yes. Last updated: 2023-07-19.
Decision dates by country: ES: 2023-07-19, FR: 2023-07-18

Condition(s): Cancer
Product: KD033

Primary endpoint: Occurrence of Dose Limiting Toxicities (DLTs): To evaluate the number of participants who experienced DLTs during the dose escalation phase, Treatment Emergent Adverse Events (TEAEs) and Treatment-related AEs by Severity: To evaluate the number of TEAEs and treatment-related AEs by severity for all dose groups/cohorts according to the National Cancer Institute Common Terminology Criteria for Adverse Events Version 5.0 (NCI CTCAE v5.0)
Endpoint(s): Best Overall Response (BOR): To evaluate the best overall response from study treatment according to Response Evaluation Criteria in Solid Tumors Version 1.1 (RECIST 1.1) and Immune Response Evaluation Criteria in Solid Tumors (iRECIST) criteria per Investigator assessment, Duration Of Response (DOR): To evaluate the duration of response from study treatment according to Response Evaluation Criteria in Solid Tumors Version 1.1 (RECIST 1.1) and Immune Response Evaluation Criteria in Solid Tumors (iRECIST) criteria per Investigator assessment, Exploration of KD033 (SAR445710) Pharmacokinetic (PK) Profile - AUC: Area under the concentration versus time curve (AUC), Exploration of KD033 (SAR445710) Pharmacokinetic (PK) Profile - Cmax: Maximum plasma concentration observed (Cmax), Exploration of Anti-KD033 (SAR445710) Antibodies: To evaluate serum titers and assessment of neutralization of anti-KD033 (SAR445710) antibodies using blood samples collected during the dose escalation and dose expansion phases

Source: https://euclinicaltrials.eu/ctis-public/view/2022-503080-15-00